EU clinical trial 2024-518987-11-00: CETUXIMAB, IRINOTECAN AND FLUOROURACILE IN FIRST-LINE TREATMENT OF IMMUNOLOGICALLY-SELECTED ADVANCED COLORECTAL CANCER PATIENTS - the CIFRA study
Sponsor: IRCCS Istituto Nazionale Tumori Fondazione Pascale (Hospital/Clinic/Other health care facility). Phase: Therapeutic exploratory (Phase II). Countries: Italy (ongoing, recruiting).
Therapeutic area(s): Diseases [C] - Neoplasms [C04]
Gender: Female, Male. Age: 18-64 years, 65+ years. Enrolment: 34.
Status: Ongoing, recruiting. Start date (EU): 2019-06-12. Decision date: 2024-11-27. Results received: No. Last updated: 2024-11-27.

Condition(s): ADCC, Colorectal Cancer
Product: CETUXIMAB, FOLINIC ACID, FLUOROURACIL, IRINOTECAN

Primary endpoint: Activity assessed by RECIST criteria version 1.1
Endpoint(s): Response duration, PFS will be determined from the date of treatment start until progression., OS will be measured from treatment start until death from any cause., Toxic effects assessed by CTCAE of the National Cancer Institute, version 4.0, June 14, 2010

Source: https://euclinicaltrials.eu/ctis-public/view/2024-518987-11-00